EU clinical trial 2024-517928-19-00: Organ preservation in locally advanced rectal cancer by radiochemotherapy followed by consolidation chemotherapy. A prospective phase II pilot trial of the German Rectal Cancer Study Group
Protocol code: CAO/ARO/AIO-16
Sponsor: Universitaetsklinikum Tuebingen AöR (Hospital/Clinic/Other health care facility). Phase: Therapeutic exploratory (Phase II). Countries: Germany (ended).
Therapeutic area(s): Diseases [C] - Neoplasms [C04]
Gender: Female, Male. Age: 18-64 years, 65+ years. Enrolment: 89.
Status: Ended. Start date (EU): 2018-04-17. End date (EU): 2025-07-30. Decision date: 2024-10-11. Results received: Yes. Last updated: 2025-02-25.

Condition(s): Male and female patients with histologically confirmed diagnosis of rectal cancer
Product: Leucovorin 10 mg/ml Lösung zur Injektion/ Infusion, 5-FU medac 50 mg/ml, Injektionslösung, ELOXATIN 5 mg/ml Konzentrat zur Herstellung einer Infusionslösung

Primary endpoint: The primary objective of the present study is to estimate the clinical complete response rate after anintensified radiochemotherapy regimen in locally advanced rectal cancer. This clinical completeresponse determined in this study will be the basis for a consecutive study using the sameradiochemotherapy regimen with 2-year local control as endpoint.

Source: https://euclinicaltrials.eu/ctis-public/view/2024-517928-19-00